EU clinical trial 2023-510446-24-00: C3651003 A PHASE 2, RANDOMIZED, DOUBLE-BLIND, PLACEBO-CONTROLLED STUDY TO INVESTIGATE THE EFFICACY, SAFETY AND TOLERABILITY OF PONSEGROMAB IN PATIENTS WITH CANCER, CACHEXIA, AND ELEVATED CONCENTRATIONS OF GDF-15, FOLLOWED BY AN OPTIONAL OPEN-LABEL TREATMENT PERIOD (PROACC -1)
Protocol code: C3651003
Sponsor: Pfizer Inc. (Pharmaceutical company). Phase: Therapeutic exploratory (Phase II). Countries: Bulgaria (ended), Poland (ended), Spain (ended), Slovakia (ended).
Therapeutic area(s): Diseases [C] - Nutritional and Metabolic Diseases [C18]
Gender: Female, Male. Age: 18-64 years, 65+ years. Enrolment: 53.
Status: Ended. Start date (EU): 2023-05-30. End date (EU): 2025-04-23. End date: 2025-04-24. Decision date: 2024-03-29. Results received: Yes. Last updated: 2025-05-22.
Decision dates by country: ES: 2024-04-01, PL: 2024-03-29, SK: 2024-04-03, BG: 2024-04-19

Condition(s): Cancer cachexia
Product: Placebo for ponsegromab (PF-06946860) solution for injection, Ponsegromab (PF-06946860)

Primary endpoint: Change from baseline body weight at Week 12.
Endpoint(s): Change from baseline in each of the physical activity and gait endpoints measured with remote digital sensors at Week 12: Moderate to vigorous physical activity time; Sedentary activity time; Non sedentary activity time; Total vector magnitude; Mean activity level during M6min; Mean gait speed; 95th percentile gait speed., Change from baseline in FAACT sub-scale scores at Week 12: FAACT-ACS; FAACT-5IASS., Change from baseline score for the questions from the CRCSD at Week 12 related to: Anorexia/appetite; Nausea and vomiting; Fatigue., Incidence of adverse events, safety laboratory tests, vital signs and ECG abnormalities

Source: https://euclinicaltrials.eu/ctis-public/view/2023-510446-24-00